EU clinical trial 2025-524885-12-00: Repurposed Drug Evaluation for Biological Aging, Pain, and Inflammation Reduction in Osteoarthritis
Protocol code: R0128381A
Sponsor: Radboud universitair medisch centrum Stichting (Hospital/Clinic/Other health care facility). Phase: Therapeutic exploratory (Phase II). Countries: Netherlands (not authorised).
Therapeutic area(s): Diseases [C] - Musculoskeletal Diseases [C05]
Gender: Female, Male. Age: 18-64 years, 65+ years. Enrolment: 175.
Status: Not authorised. Decision date: 2026-05-26. Results received: No. Last updated: 2026-05-26.

Condition(s): Osteoarthritis
Product: Tivicay 50 mg film-coated tablets, METFORMINE HCL SANDOZ 500 MG, filmomhulde tabletten, Colchicine CF 0,5 mg, tabletten, Olumiant 2 mg film-coated tablets

Primary endpoint: Change in epigenetic and biological age acceleration before and after medication use.
Endpoint(s): Change in inflammatory proteins and cytokines in the circulation before and after medication use., Change in pain severity and the knee osteoarthritis biomarkers in the blood and urine before and after medication use., Safety of the drug combinations assessed by the proportion of treatment emergent adverse events and grade 3/4 laboratory abnormalities.

Source: https://euclinicaltrials.eu/ctis-public/view/2025-524885-12-00